EU clinical trial 2023-507146-91-00: A Phase 3, Multi-Center, Open Label Extension Study to Assess the Safety and Efficacy of Viltolarsen in Ambulant Boys with Duchenne Muscular Dystrophy (DMD)
Protocol code: NS-065/NCNP-01-302
Sponsor: Ns Pharma Inc. (Pharmaceutical company). Phase: Therapeutic confirmatory (Phase III). Countries: Spain (ended), Italy (ended), Greece (ended), Norway (ended), Czechia (ended), Netherlands (ended).
Therapeutic area(s): Diseases [C] - Musculoskeletal Diseases [C05]
Gender: Male. Age: 0-17 years. Enrolment: 21.
Status: Ended. Start date (EU): 2021-06-07. End date (EU): 2025-01-16. End date: 2025-11-03. Decision date: 2024-02-26. Results received: No. Last updated: 2025-06-18.
Decision dates by country: CZ: 2024-02-27, NO: 2024-02-27, NL: 2024-02-27, IT: 2024-03-01, GR: 2024-04-09, ES: 2024-02-26

Condition(s): Duchenne Muscular Dystrophy (DMD)
Product: Viltolarsen

Primary endpoint: - Vital signs - Physical examination - Clinical laboratory tests o Hematology and clinical chemistry o Urinalysis o Urine cytology - Antibodies to dystrophin and viltolarsen - 12-lead electrocardiogram (ECG) - Renal ultrasound - Treatment-emergent adverse events (TEAEs) and serious adverse events (SAEs)
Endpoint(s): Secondary: - Time to Stand Test (TTSTAND) - Time to Run/Walk 10 Meters Test (TTRW) - Six-minute Walk Test (6MWT) - North Star Ambulatory Assessment (NSAA) - Time to Climb 4 Stairs Test (TTCLIMB) - Quantitative muscle strength measured by hand-held dynamometer (elbow extension, elbow flexion, knee extension, and knee flexion on the dominant side only)

Source: https://euclinicaltrials.eu/ctis-public/view/2023-507146-91-00